EU clinical trial 2024-512559-20-01: The additive effect of ketamine in combination with electroconvulsive stimulation (ECS) in major depressive disorder (MDD): a translational study
Protocol code: PRIN - 20227EA9AN
Sponsor: Universita' Vita-salute S. Raffaele (Educational Institution). Phase: Therapeutic confirmatory (Phase III). Countries: Italy (ongoing, recruiting).
Therapeutic area(s): Psychiatry and Psychology [F] - Mental Disorders [F03]
Gender: Female, Male. Age: 18-64 years, 65+ years. Enrolment: 30.
Status: Ongoing, recruiting. Start date (EU): 2025-07-10. Decision date: 2025-02-17. Results received: No. Last updated: 2026-03-02.

Condition(s): Major Depressive Disorder (MDD)
Product: SODIO CLORURO 0,9% BAXTER Soluzione per infusione, KETAMINA MOLTENI 50 mg/ml soluzione iniettabile

Primary endpoint: The primary endpoint is the mean change in depressive symptoms, as measured by the Montgomery-Åsberg Depression Rating Scale (MADRS), from baseline to Day 28 (Week 4 +/- 4 days). This will assess the short-term efficacy of the treatment.
Endpoint(s): The secondary endpoints include changes in suicidal ideation, anxiety symptoms, cognitive function, dissociative and psychotic symptoms, and neurochemical markers. Suicidal ideation will be measured by the Beck Scale for Suicide Ideation (BSSI), with mean change from baseline to Week 4 and Week 12 as the primary outcome of interest. Anxiety symptoms will be assessed using the Hamilton Anxiety Rating Scale (HAM-A), with evaluations conducted from baseline through Week 12 to capture changes across

Source: https://euclinicaltrials.eu/ctis-public/view/2024-512559-20-01